EU clinical trial 2025-521752-26-00: A Phase 2 Study to Assess ADX-038 in Participants With Complement-Mediated Kidney Disease
Protocol code: ADX-038-201
Sponsor: Adarx Pharmaceuticals Inc. (Pharmaceutical company). Phase: Therapeutic exploratory (Phase II). Countries: Spain (ongoing, recruiting), Italy (ongoing, recruiting).
Therapeutic area(s): Diseases [C] - Male Urogenital Diseases [C12]; Diseases [C] - Female Urogenital Diseases and Pregnancy Complications [C13]
Gender: Female, Male. Age: 18-64 years, 65+ years. Enrolment: 7.
Status: Ongoing, recruiting. Start date (EU): 2026-04-22. Decision date: 2026-03-02. Results received: No. Last updated: 2026-06-12.
Decision dates by country: ES: 2026-03-06, IT: 2026-03-02

Condition(s): Complement-Mediated Kidney Disease
Product: Nimenrix powder and solvent for solution for injection in pre-filled syringe Meningococcal groups A, C, W-135 and Y conjugate vaccine, Nimenrix powder and solvent for solution for injection in pre-filled syringe Meningococcal groups A, C, W-135 and Y conjugate vaccine, Infanrix hexa, Powder and suspension for suspension for injection. Diphtheria (D), tetanus (T), pertussis (acellular, component) (Pa), hepatitis B (rDNA) (HBV), poliomyelitis (inactivated) (IPV) and Haemophilus influenzae type b (Hib) conjugate vaccine (adsorbed)., Bexsero suspension for injection in pre-filled syringe Meningococcal group B Vaccine (rDNA, component, adsorbed), Nimenrix powder and solvent for solution for injection in pre-filled syringe Meningococcal groups A, C, W-135 and Y conjugate vaccine, Infanrix hexa, Powder and suspension for suspension for injection. Diphtheria (D), tetanus (T), pertussis (acellular, component) (Pa), hepatitis B (rDNA) (HBV), poliomyelitis (inactivated) (IPV) and Haemophilus influenzae type b (Hib) conjugate vaccine (adsorbed)., ADX-038, Bexsero suspension for injection in pre-filled syringe Meningococcal group B Vaccine (rDNA, component, adsorbed), Bexsero suspension for injection in pre-filled syringe Meningococcal group B Vaccine (rDNA, component, adsorbed), Infanrix hexa, Powder and suspension for suspension for injection. Diphtheria (D), tetanus (T), pertussis (acellular, component) (Pa), hepatitis B (rDNA) (HBV), poliomyelitis (inactivated) (IPV) and Haemophilus influenzae type b (Hib) conjugate vaccine (adsorbed)., Bexsero suspension for injection in pre-filled syringe Meningococcal group B Vaccine (rDNA, component, adsorbed), Nimenrix powder and solvent for solution for injection in pre-filled syringe Meningococcal groups A, C, W-135 and Y conjugate vaccine, Prevenar 20 suspension for injection in pre-filled syringe Pneumococcal polysaccharide conjugate vaccine (20-valent, adsorbed), Infanrix hexa, Powder and suspension for suspension for injection. Diphtheria (D), tetanus (T), pertussis (acellular, component) (Pa), hepatitis B (rDNA) (HBV), poliomyelitis (inactivated) (IPV) and Haemophilus influenzae type b (Hib) conjugate vaccine (adsorbed)., Prevenar 20 suspension for injection in pre-filled syringe Pneumococcal polysaccharide conjugate vaccine (20-valent, adsorbed), Prevenar 20 suspension for injection in pre-filled syringe Pneumococcal polysaccharide conjugate vaccine (20-valent, adsorbed), Prevenar 20 suspension for injection in pre-filled syringe Pneumococcal polysaccharide conjugate vaccine (20-valent, adsorbed)

Primary endpoint: Incidence and severity of TEAEs
Endpoint(s): 1. Change from baseline in UPCR as measured by 24-hour urine over time, 2. Change from baseline in UPCR as measured by spot urine over time

Source: https://euclinicaltrials.eu/ctis-public/view/2025-521752-26-00